EU clinical trial 2024-514135-17-00: A Phase 3, Randomized, Double-Blind, Placebo-Controlled Study of Povetacicept in Adults with Immunoglobulin A Nephropathy (RAINIER).
Protocol code: AIS-D08
Sponsor: Alpine Immune Sciences Inc. (Pharmaceutical company). Phase: Therapeutic confirmatory (Phase III). Countries: Norway (ongoing, recruitment ended), Latvia (ongoing, recruitment ended), Hungary (ongoing, recruitment ended), Poland (ongoing, recruitment ended), Austria (ongoing, recruitment ended), Belgium (ended), Ireland (ongoing, recruitment ended), Netherlands (ongoing, recruitment ended), France (ongoing, recruitment ended), Denmark (ongoing, recruitment ended), Croatia (ongoing, recruitment ended), Italy (ongoing, recruitment ended), Finland (ended), Spain (ongoing, recruitment ended), Czechia (ongoing, recruitment ended), Estonia (ongoing, recruitment ended), Sweden (ongoing, recruitment ended), Lithuania (ongoing, recruitment ended), Germany (ongoing, recruitment ended).
Therapeutic area(s): Diseases [C] - Female Urogenital Diseases and Pregnancy Complications [C13]; Diseases [C] - Male Urogenital Diseases [C12]
Gender: Female, Male. Age: 18-64 years, 65+ years. Enrolment: 181.
Start date (EU): 2024-11-28. Decision date: 2024-11-11. Results received: No. Last updated: 2026-05-25.
Decision dates by country: FI: 2024-11-13, BE: 2024-11-20, AT: 2024-11-18, HR: 2024-11-19, CZ: 2024-11-12, DK: 2024-11-12, EE: 2024-11-18, FR: 2024-11-12, DE: 2024-11-13, HU: 2024-11-15, IE: 2024-11-15, IT: 2024-11-14, LT: 2024-11-13, ES: 2024-11-14, SE: 2024-11-11, NO: 2024-11-14, PL: 2024-11-18, LV: 2024-11-15, NL: 2024-11-14

Condition(s): Immunoglobulin A Nephropathy
Product: ALPN-303 solution for injection, Test IMP without active substance, Test IMP ALPN-303 pre-filled syringe without active substance, ALPN-303 solution for injection in pre-filled syringe

Primary endpoint: 1. Change From Baseline in 24-hour Urine Protein to Creatinine Ratio (uPCR) at Week 36 [Time Frame: From Baseline at Week 36]., 2. Total Estimated Glomerular Filtration Rate (eGFR) Slope Through Week 104 [Time Frame: From Baseline Through Week 104].
Endpoint(s): 3. Change From Baseline in eGFR at Week 104 [Time Frame: From Baseline at Week 104]., 4. Time to Kidney Disease Progression Through Week 104 Kidney disease progression defined as greater than or equal to (≥) 30% decline in eGFR, end stage kidney disease, or non-accidental death. [Time Frame: From Baseline Through Week 104]., 1. Change from baseline in serum Gd-IgA1 at Week 36, 2. Proportion of subjects to achieve hematuria resolution at Week 36 (among subjects with hematuria at baseline)

Source: https://euclinicaltrials.eu/ctis-public/view/2024-514135-17-00